EU clinical trial 2023-505855-32-01: Randomized and open clinical trial to compare the efficacy and safety of Buckberg versus Del Nido cardioplegia in isolated myocardial revascularization surgery
Protocol code: IIBSP-CAR-2023-74
Sponsor: Fundacio Institut De Recerca De L Hospital De La Santa Creu I Sant Pau (Hospital/Clinic/Other health care facility). Phase: Therapeutic use (Phase IV). Countries: Spain (ongoing, recruiting).
Therapeutic area(s): Analytical,Diagnostic,Therapeutic Techniques and Equipment [E]-Surgical Procedures, Operative [E04]; Diseases [C] - Cardiovascular Diseases [C14]
Gender: Female, Male. Age: 18-64 years, 65+ years. Enrolment: 286.
Status: Ongoing, recruiting. Start date (EU): 2024-03-20. Decision date: 2024-02-15. Results received: No. Last updated: 2024-02-15.

Condition(s): Cardiovascular pathology
Product: CARDIOPLEGIA SOLUTIONS

Primary endpoint: Markers of myocardial damage: Peak levels of CK in U/L and ultrasensitive Troponin T in ng/L in blood. Basal levels will be determined daily during the first 5 postoperative days. The peak of CK and Troponin T will be recorded for each of the study subjects (usually it occurs during postoperative days 2 and 4)., Operative mortality. Operative mortality will be considered mortality in the following 30 days after the surgical intervention, or mortality during admission for the intervention (in patients whose admission exceeds 30 postoperative days).
Endpoint(s): Aortic clamping time (minutes), Extracorporeal circulation time (minutes), Spontaneous recovery of the rhythm after aortic unclamping: it will be recorded during the intraoperative period if there is spontaneous recovery of the cardiac rhythm after removing the aortic clamp., Need for post-aortic unclamping defibrillation: it will be recorded if defibrillation is necessary to recover one's own heart rhythm., Need for inotropes for weaning from CPB: it will be recorded if the administration of inotropes is necessary for weaning from CPB. If yes, the type and maximum dose of inotrope required will be recorded., Maximum intraoperative blood glucose (in mmol/L)., Intraoperative insulin needs and during the 48 hours postoperatively., Minimum intraoperative, postoperative and discharge hemoglobin (in g/L)., Maximum intraoperative lactate (in mmol/L),, Need for intraoperative and postoperative red blood cell transfusion., Inotrope need and duration during intra- and postoperative., Need for mechanical circulatory assistance: need for circulatory support using a counterpulsation balloon or ECMO., Perioperative myocardial infarction according to the 5th universal definition., Episodes of de novo atrial fibrillation., Intubation hours., Left ventricular function by echocardiography at discharge., Cardiac resonance (subgroup of patients): one pre-surgery and another 7-10 days after surgery with cine sequences, mapping and late enhancement., Days of admission to the ICU., Total hospitalization days.

Source: https://euclinicaltrials.eu/ctis-public/view/2023-505855-32-01